EU clinical trial 2023-506315-17-00: A Phase 1/2 Open-Label Rolling-Arm Umbrella Platform Design of Investigational Agents With or Without Pembrolizumab or Pembrolizumab Alone in Participants With Melanoma (KEYMAKER-U02): Substudy 02D
Protocol code: MK-3475-02D
Sponsor: Merck Sharp & Dohme LLC (Pharmaceutical company). Phase: Phase I and Phase II (Integrated)- Other. Countries: Hungary (ended), Poland (ended), Greece (ended), Spain (ended), Italy (ended), France (ended).
Therapeutic area(s): Diseases [C] - Neoplasms [C04]
Gender: Female, Male. Age: 18-64 years, 65+ years. Enrolment: 49.
Status: Ended. Start date (EU): 2021-06-25. End date (EU): 2025-10-17. End date: 2025-10-18. Decision date: 2024-01-23. Results received: No. Last updated: 2025-11-24.
Decision dates by country: GR: 2024-01-26, IT: 2024-04-24, HU: 2024-01-25, PL: 2024-01-26, FR: 2024-04-29, ES: 2024-01-25

Condition(s): Advanced melanoma with brain metastases, PD-1 refractory or PD-1 naive
Product: Lenvatinib, KEYTRUDA 25 mg/mL concentrate for solution for infusion, Lenvatinib, MK-1308A

Primary endpoint: Percentage of Participants who Experience an Adverse Event (AE), Percentage of Participants who Discontinue Study Treatment Due to an AE, Objective Response Rate (ORR)
Endpoint(s): Duration of Response (DOR), Brain Metastasis Response Rate (BMRR), Brain Metastasis Duration of Response (BM-DOR), Progression-free Survival (PFS)

Source: https://euclinicaltrials.eu/ctis-public/view/2023-506315-17-00